EU clinical trial 2022-502078-17-00: Ezurpimtrostat autophagy inhibitor in association with Atezolizumab-Bevacizumab in first line treatment of unresectable hepatocellular carcinoma, a phase 2b randomized trial. ABE-LIVER
Protocol code: 38RC210434 ABE LIVER
Sponsor: Centre Hospitalier Universitaire De Grenoble (Pharmaceutical company). Phase: Therapeutic exploratory (Phase II). Countries: France (ended).
Therapeutic area(s): Diseases [C] - Digestive System Diseases [C06]
Gender: Female, Male. Age: 18-64 years, 65+ years. Enrolment: 196.
Status: Ended. Start date (EU): 2022-12-15. End date (EU): 2024-03-08. Decision date: 2022-11-30. Results received: Yes. Last updated: 2023-08-22.

Condition(s): unresectable hepatocellular carcinoma
Product: Oyavas 25 mg/mL concentrate for solution for infusion 400 mg, Zirabev 25 mg/ml concentrate for solution for infusion., Abevmy 25 mg/mL concentrate for solution for infusion., Tecentriq 1,200 mg concentrate for solution for infusion, Alymsys 25mg/mL concentrate for solution for infusion., Avastin 25 mg/ml concentrate for solution for infusion, Avastin 25 mg/ml concentrate for solution for infusion, Aybintio 25 mg/ml concentrate for solution for infusion., MVASI 25 mg/mL concentrate for solution for infusion, MVASI 25 mg/mL concentrate for solution for infusion, GNS561

Primary endpoint: Progression-Free Survival (PFS), defined as the time from randomization to the occurrence of disease progression or death from any cause, whichever occurs first. Progression events will be considered based on centralized tumor response assessment according to RECIST version 1.1 and PFS analyses will be performed by the CHU Grenoble Alpes Statistics department.
Endpoint(s): To assess the tumor response under the association of Ezurpimtrostat with Atezolizumab-Bevacizumab in first line setting in unresectable hepatocellular carcinoma, To assess the impact of the association Ezurpimtrostat + Atezolizumab-Bevacizumab on Overall Survival (OS), To assess the duration of response of the association Ezurpimtrostat + Atezolizumab-Bevacizumab, To assess the Alpha-fetoprotein (AFP) response at 3, 6, 12 months under the association Ezurpimtrostat + Atezolizumab-Bevacizumab, To assess the overall survival rate at 6, 12-months under the association Ezurpimtrostat + Atezolizumab-Bevacizumab, To assess the progression free survival rate at 6, 12-months under the association Ezurpimtrostat + Atezolizumab-Bevacizumab, To assess the safety of the association Ezurpimtrostat + Atezolizumab-Bevacizumab, To assess the Quality of life (by EORTC QLQ-C30 score) and the time to deterioration (TTD) under the association Ezurpimtrostat + Atezolizumab-Bevacizumab, To assess the predictive value of CD4/CD8 intratumor infiltrate on tumor response and survival outcomes, To assess the predictive value of PPT1 baseline expression on tumor response and survival outcomes, Pharmacokinetic (PK) and pharmacodynamics (PD) study of Ezurpimtrostat in association with Atezolizumab-Bevacizumab, Peripheral blood mononuclear cell (PBMC) biobanking for further ancillary studies

Source: https://euclinicaltrials.eu/ctis-public/view/2022-502078-17-00